EU clinical trial 2023-506596-10-00: AN OPEN LABEL, TWO PERIODS, TWO SEQUENCES, CROSSOVER, RANDOMIZED MULTIPLE DOSE BIOEQUIVALENCE STUDY OF GUANFACINE 7 MG PROLONGED-RELEASE TABLETS (TEST FORMULATION) VS. EQUAL DOSE OF INTUNIV® PROLONGED-RELEASE TABLETS (REFERENCE FORMULATION) IN HEALTHY MALE VOLUNTEERS UNDER FASTING CONDITIONS
Protocol code: GFC-BEMD-01-NXP/23
Sponsor: neuraxpharm Arzneimittel GmbH (Pharmaceutical company). Phase: Human Pharmacology (Phase I)- Bioequivalence Study. Countries: Romania (ended).
Therapeutic area(s): Psychiatry and Psychology [F] - Mental Disorders [F03]
Gender: Male. Age: 18-64 years. Enrolment: 42.
Status: Ended. Start date (EU): 2024-01-31. End date (EU): 2024-05-13. Decision date: 2024-01-19. Results received: No. Last updated: 2024-01-19.

Condition(s): Study performed on healthy volunteers.

Source: https://euclinicaltrials.eu/ctis-public/view/2023-506596-10-00